EU clinical trial 2023-509209-54-00: A study in healthy men to test whether esomeprazole influences the amount of BI 3000202 in the blood
Protocol code: 1509-0007
Sponsor: Boehringer Ingelheim International GmbH (Pharmaceutical company). Phase: Human Pharmacology (Phase I)- Other. Countries: Germany (ended).
Therapeutic area(s): Not possible to specify
Gender: Male. Age: 18-64 years. Enrolment: 16.
Status: Ended. Start date (EU): 2024-05-21. End date (EU): 2024-07-08. Decision date: 2024-03-18. Results received: No. Last updated: 2024-03-18.

Condition(s): Healthy volunteer trial

Source: https://euclinicaltrials.eu/ctis-public/view/2023-509209-54-00